EU clinical trial 2025-521234-28-00: Eight weeks of low dose hCG priming in women with diminished ovarian reserve undergoing IVF/ICSI – a randomized controlled trial
Sponsor: Rigshospitalet (Hospital/Clinic/Other health care facility). Phase: Therapeutic confirmatory (Phase III). Countries: Denmark (authorised, recruiting).
Therapeutic area(s): Diseases [C] - Female Urogenital Diseases and Pregnancy Complications [C13]
Gender: Female. Age: 18-64 years. Enrolment: 80.
Status: Authorised, recruiting. Start date (EU): 2025-09-10. Decision date: 2025-06-03. Results received: No. Last updated: 2025-06-03.

Condition(s): Infertility, diminished ovarian reserve.
Product: Natriumklorid 9 mg/ml (0,5 ml injektionsvæske), Ovitrelle 250 micrograms/0.5 mL solution for injection in pre-filled syringe

Primary endpoint: The number of oocytes retrieved after hCG vs placebo priming
Endpoint(s): Antral follicle count, AMH, number of follicles, number of fertilized eggs, number of cleaved day 2 embryos, number of good and top quality day 2 embryos, number of blastocysts, cycle cancellation rate, Reproductive hormone levels, granulosa cell receptor expression, prenancy and live birth rates

Source: https://euclinicaltrials.eu/ctis-public/view/2025-521234-28-00